EU clinical trial 2022-501781-22-00: Open-label, Phase 3b study to evaluate effectiveness, safety and pharmacokinetic parameters of metreleptin in patients under 6 years of age with generalised lipodystrophy and associated diabetes mellitus and/or hypertriglyceridaemia
Protocol code: APL-20
Sponsor: Amryt Pharmaceuticals Designated Activity Company (Pharmaceutical company). Phase: Therapeutic confirmatory (Phase III). Countries: Italy (ended), Germany (ended), Belgium (ended), France (ended).
Therapeutic area(s): Phenomena and Processes [G] - Metabolism [G03]
Gender: Female, Male. Age: 0-17 years. Enrolment: 25.
Status: Ended. Start date (EU): 2024-02-09. End date (EU): 2026-05-11. Decision date: 2023-05-03. Results received: No. Last updated: 2026-03-25.
Decision dates by country: FR: 2024-03-08, DE: 2023-05-08, IT: 2023-05-03, BE: 2024-03-15

Condition(s): Generalised lipodystrophy
Product: Myalepta 3 mg powder for solution for injection, Myalepta 5.8 mg powder for solution for injection

Primary endpoint: Percent change from baseline in fasting serum TG levels at Month 12 for subjects with fasting TG levels ≥2.3 mmol/L (200 mg/dL) at baseline, Absolute change from baseline in glycated haemoglobin (HbA1c) at Month 12 for subjects with HbA1c ≥6.5% at baseline
Endpoint(s): Proportion of subjects of those with Baseline HbA1c ≥6.5% achieving target actual decreases of at least 0.5%, 1%, 1.5%, 2% absolute decrease in HbA1c or HbA1c <6.5% or HbA1c <5.7% at Month 12, Proportion of subjects of those with Baseline HbA1c ≥5.7% achieving target actual decreases of at least 0.5%, 1%, 1.5%, 2% absolute decrease in HbA1c or HbA1c <5.7% at Month 12, Proportion of subjects of those with fasting serum TG ≥ 1.7 mmol/L (150 mg/dL) achieving target actual decreases from baseline of at least 15%, 20%, 25%, 30%, 35%, 40% at Month 12, Proportion of subjects of those with fasting serum TG ≥ 2.3 mmol/L (200 mg/dL) achieving target actual decreases from baseline of at least 15%, 20%, 25%, 30%, 35%, 40% at Month 12, Percent change from baseline in fasting serum TG levels at Month 12 for subjects with fasting TG levels ≥1.7 mmol/L (150 mg/dL) at baseline, Absolute change from baseline in HbA1c at Month 12 for subjects with HbA1c ≥5.7% at baseline, Actual change from baseline to Month 12 in fasting plasma glucose (FPG) levels overall and in subjects with baseline FPG above normal, Change from baseline to Month 6, 9 and 12 in fasting insulin in subjects with fasting insulin above upper limit of normal at baseline, Change from baseline in liver volume and liver span as assessed by ultrasound at each post-baseline visit through Month 12, Proportion of subjects with decreased severity of hepatic steatosis based on ultrasound in subjects with hepatic steatosis, Change from baseline in liver fibrosis scores as assessed by liver elastography, Change in liver transaminase levels (AST, ALT) in subjects with elevated transaminase levels at baseline, Proportion of subjects with normal transaminase levels (AST, ALT) in subjects with elevated transaminase levels at baseline, Change in use of medications (e.g., insulin) from screening through Month 12, Change in Pediatric Quality of Life Inventory (PedsQL)/ PedsQL Infant Scales from baseline to Month 6 and to Month 12, Change over time in total leptin as determined by Enzyme-linked Immunosorbent Assay (ELISA) in all ADA-positive subjects, Change over time in total leptin as determined by ELISA in blocking antibody-positive subjects, Correlation of endogenous leptin levels with clinical events (i.e., loss of efficacy or serious/severe infections), Change over time in endogenous leptin levels as determined by Mass Spectrometry in all ADA positive subjects versus ADA negative subjects, Change in Hyperphagia Questionnaire for Clinical Trials (HQ-CT) from baseline to each post-baseline visit through Month 12

Source: https://euclinicaltrials.eu/ctis-public/view/2022-501781-22-00